EU clinical trial 2024-510987-22-00: A Phase 2 Pilot Study to Evaluate the Safety and the Anti-Tumour Activity of the Myc Inhibitor OMO-103 Administered Intravenously in Patients with Advanced High-Grade Osteosarcoma
Protocol code: VHIO23003(OMO-103-03
Sponsor: Vall D Hebron Institute Of Oncology (Laboratory/Research/Testing facility). Phase: Therapeutic exploratory (Phase II). Countries: Spain (temporarily halted).
Therapeutic area(s): Diseases [C] - Neoplasms [C04]
Gender: Female, Male. Age: 0-17 years, 18-64 years, 65+ years. Enrolment: 10.
Status: Temporarily halted. Start date (EU): 2024-12-30. Decision date: 2024-09-23. Results received: No. Last updated: 2025-11-19.

Condition(s): Advanced High-Grade Osteosarcoma
Product: Omomyc

Primary endpoint: Progression-free survival rate at 16 weeks (16-week PFS) according to RECIST V1.1 by Investigator assessment.
Endpoint(s): • Objective Response Rate (ORR) • Disease Control Rate (DCR) • Time to Progression (TTP) • Time to Response (TTR) • Duration of Response (DOR) • Overall survival (OS), • Incidence and severity of adverse events (AEs), graded by Common Terminology Criteria for Adverse Events (CTCAE) version 5.0.• Safety will be assessed through routine monitoring of adverse events, evaluation of laboratory parameters, vital signs, physical examination and ECGs., PK parameters of OMO-103: AUC; Cmax; tmax; t1/2., • Health-related quality of life (HRQoL) measured by the European Organisation for Research and Treatment of Cancer Quality of Life Questionnaire – Core 30 items (EORTC-C30) for adult patients, and by the Pediatric Quality of Life Inventory (PedsQL) for patients between 12 and 17., • Q-TWiST approach [time experiencing toxicity (grade 3/4 AEs) before progression, time without toxicity or symptoms of progression, and time after progression]

Source: https://euclinicaltrials.eu/ctis-public/view/2024-510987-22-00